EU clinical trial 2023-506582-58-00: A Phase 1b Study of Bleximenib in Combination with AML Directed Therapies for Participants with Acute Myeloid Leukemia Harboring KMT2A or NPM1 Alterations
Protocol code: 75276617ALE1002
Sponsor: Janssen - Cilag International (Pharmaceutical company). Phase: Human Pharmacology (Phase I)- Other. Countries: France (ongoing, recruitment ended), Italy (ongoing, recruitment ended), Spain (ongoing, recruitment ended), Germany (ongoing, recruitment ended).
Therapeutic area(s): Diseases [C] - Neoplasms [C04]
Gender: Female, Male. Age: 0-17 years, 18-64 years, 65+ years. Enrolment: 86.
Status: Ongoing, recruitment ended. Start date (EU): 2022-07-21. Decision date: 2024-03-18. Results received: No. Last updated: 2025-10-03.
Decision dates by country: DE: 2024-03-18, ES: 2024-03-18, IT: 2024-03-18, FR: 2024-03-18

Condition(s): Acute Myeloid Leukemia
Product: Citarabina Hikma 2 g/20mL Soluzione Iniettabile, Idarubicin Hikma 1 mg/ml Injektionslösung, Cytarabine 100 mg/ml Solution for Injection or Infusion, Cytarabine 100 mg/ml Solution for Injection or Infusion, Daunoblastin® 20 mg Pulver zur Herstellung einer Infusions- oder Injektionslösung, JNJ-75276617, JNJ-75276617 (G022), Venclyxto 100 mg film-coated tablets, Idarubicin, Venclyxto 100 mg film-coated tablets, JNJ-75276617, JNJ-75276617 (G023), Azacitidine, JNJ-75276617, Citarabina Hikma 500mg/5mL Soluzione Iniettabile, JNJ-75276617, JNJ-75276617 (G021), JNJ-75276617 (G007), Venclyxto 50 mg film-coated tablets, JNJ-75276617 (G008), CYTARABINE ACCORD 100 mg/ml, solution injectable ou pour perfusion, JNJ-75276617 (G024), Azacitidine

Primary endpoint: 1. Incidence and severity of AEs, including DLTs, 2. Incidence and severity of Aes

Source: https://euclinicaltrials.eu/ctis-public/view/2023-506582-58-00